EU clinical trial 2024-514642-37-00: The effect of handheld-multimedia versus midazolam premedication on the level of perioperative anxiety in pediatric day-care. A randomized controlled trial.
Sponsor: UZ Brussel (Hospital/Clinic/Other health care facility). Phase: Therapeutic use (Phase IV). Countries: Belgium (ongoing, recruiting).
Therapeutic area(s): Analytical, Diagnostic and Therapeutic Techniques and Equipment [E] - Anesthesia and Analgesia [E03]
Gender: Female, Male. Age: 0-17 years. Enrolment: 150.
Status: Ongoing, recruiting. Start date (EU): 2020-01-31. Decision date: 2024-07-10. Results received: No. Last updated: 2024-07-10.

Condition(s): Perioperative anxiety in children scheduled for an elective circumcision, dental care or tonsillectomy/adenoidectomy in day-care
Product: BUCCOLAM 2.5 mg oromucosal solution, Midazolam Rowa 2.5 mg oromucosal solution

Primary endpoint: Primary endpoints are the difference in perioperative anxiety between the two groups measured with mYpas-score and parental-scoring with the 5-point anxiety scale.
Endpoint(s): Stressful inductions (anesthetic satisfaction) Definition of stressful anesthetic inductions will be qualified by scaling and noted by the anesthesiologist, directly post-induction. XML File Identifier: Mmsidp0h9a5a/NwZENxH2Odvq/w= Page 15/25 1. Cooperative Smooth Induction: no crying, no unrest 2. Passive induction: crying, no unrest 3. Anxious induction: crying and unrest 4. Combative induction: total hysteric 2. Parental scoring for anxiety of the patient, Parental scoring for anxiety of the patient will be done by the following the 5-point anxiety scale used: 1. Happy (playing) 2. Happy/little worried (playing cautiously) 3. Worried (no playing, silently) 4. Anxious (crying) 5. Hysterical (crying and screaming) Parental scoring will be done, on the daycare preoperative, on the holding, postoperative on the recovery., Respiratory postoperative complications Scored directly post-induction and post detubation - Laryngospasm: Four-point scale (17) 1. No Laryngospasm 2. Mild laryngospasm (relieved by jaw thrust and 100% oxygen) 3. Moderate laryngospasm (relieved by 100% oxygen and positive pressure ventilation) 4. Severe laryngospasm (relieved by succinylcholine and intubation), Bronchospasm/wheezing 1. Yes 2. No • In absence of a scale, Parental Satisfaction on the anxiety-management perioperative: measured on holding, after induction, recovery, postop daycare unit. 1. Extremely satisfied 2. Satisfied 3. Neutral 4. Unsatisfied 5. Extremely Unsatisfactory, Postoperative POCIS-Score by leaving the recovery. POCIS is more suitable for young children then the traditional VAS-score (18) See Appendix III of the protocol, Preoperative sedation or negative behavior Evaluation of sedation or possible negative behavior preoperative after midazolam is done by the RASS-score. (19) See Appendix III of the protocol

Source: https://euclinicaltrials.eu/ctis-public/view/2024-514642-37-00